EU clinical trial 2024-516144-25-00: A Multicentre, Randomized Trial of Catheter-directed thrombolysis in intermediate-high risk acute pulmonary embolism (PRAGUE-26)
Protocol code: PRAGUE-26
Sponsor: Fakultni Nemocnice Kralovske Vinohrady (Hospital/Clinic/Other health care facility). Phase: Therapeutic use (Phase IV). Countries: Czechia (authorised, recruitment pending).
Therapeutic area(s): Diseases [C] - Cardiovascular Diseases [C14]
Gender: Female, Male. Age: 18-64 years, 65+ years. Enrolment: 558.
Status: Authorised, recruitment pending. Decision date: 2024-10-02. Results received: No. Last updated: 2025-03-12.

Condition(s): intermediate-high risk acute pulmonary embolism
Product: ACTILYSE 1 mg/ml prášek a rozpouštědlo pro injekční/infuzní roztok

Primary endpoint: All-cause mortality – [ Time Frame: Within 7 days of randomization ], PE recurrence (non-fatal symptomatic and objectively confirmed recurrence of PE by repeated CTA) – [ Time Frame: Within 7 days of randomization ], Cardiorespiratory decompensation or collapse* – [ Time Frame: Within 7 days of randomization ]
Endpoint(s): All individual components of primary endpoint – [ Time Frame: Within 7 days, 30 days, and 12 months ], First-line therapy failure** – [ Time Frame: Hospitalization ], Ischemic or haemorrhagic stroke [ Time Frame: Within 7 days and 30 days ], Serious adverse events – [ Time Frame: Within 12 months ], Duration of hospitalization for the index acute PE event (Time from admission to discharge from hospital) – [ Time Frame: Within 30 days ], Duration of stay at the intensive, intermediate or coronary care unit during hospitalization for the index acute PE event (Time from admission to discharge from ICU, intermediate, or CCU) – [ Time Frame: Within 30 days ], Hospitalization cost (cost-effectiveness analysis) – [ Time Frame: Within 30 days ], GUSTO major (moderate and severe) bleeding*** – [ Time Frame: Within 30 days ], International Society on Thrombosis and Hemostasis (ISTH) major bleeding**** – [ Time Frame: Within 30 days ], All bleeding complications scored by the Bleeding Academic Research Consortium (BARC) classification – [ Time Frame: Within 30 days and 12 months ], Change in the RV-to-LV diameter ratio, systolic pulmonary artery pressure (sPAP), Tricuspid annular plane systolic excursion (TAPSE), Tissue Doppler imaging-derived Tricuspid lateral annular Systolic Velocity (S´ TDI) as measured by echocardiography – [ Time Frame: Between Randomization and 24±3 hours, at 30 days, 12 months and 24 months ], Functional status as measured by World Health Organization (WHO) functional class***** – [ Time Frame: Discharge, 30 days, 12 months and 24 months ], Functional status as measured by 6-Minute Walk Test (6MWT) ****** – [ Time Frame: 12 months and 24 months ], Quality of life using EQ-5D scale******* – [ Time Frame: 30 days, 12 months and 24 months ], Diagnosis of chronic thromboembolic pulmonary hypertension (CTEPH) – [ Time Frame: Within 24 months ]

Source: https://euclinicaltrials.eu/ctis-public/view/2024-516144-25-00